EU clinical trial 2024-517136-21-00: A Phase 3, Randomized, Open-label Study of Belzutifan + Zanzalintinib Versus Cabozantinib in Participants with Advanced RCC who Experienced Disease Recurrence During or After Prior Adjuvant Anti-PD-1/L1 Therapy (LITESPARK-033)
Protocol code: MK-6482-033
Sponsor: Merck Sharp & Dohme LLC (Pharmaceutical company). Phase: Therapeutic confirmatory (Phase III). Countries: Greece (ongoing, recruiting), Germany (ongoing, recruiting), France (ongoing, recruiting), Italy (ongoing, recruiting), Croatia (ongoing, recruiting), Denmark (ongoing, recruiting), Czechia (ongoing, recruiting), Austria (ongoing, recruiting), Belgium (ongoing, recruiting), Ireland (ongoing, recruiting), Spain (ongoing, recruiting), Poland (ongoing, recruiting).
Therapeutic area(s): Diseases [C] - Neoplasms [C04]
Gender: Female, Male. Age: 18-64 years, 65+ years. Enrolment: 398.
Status: Ongoing, recruiting. Start date (EU): 2025-12-05. Decision date: 2025-11-10. Results received: No. Last updated: 2026-03-13.
Decision dates by country: AT: 2025-11-17, GR: 2025-11-11, HR: 2025-11-17, PL: 2025-11-15, CZ: 2025-11-13, BE: 2025-11-10, IT: 2025-11-11, IE: 2025-11-14, DE: 2025-11-13, ES: 2025-11-17, FR: 2025-11-17, DK: 2025-11-11

Condition(s): Renal Cell Carcinoma
Product: Cabozantinib Ipsen 60 mg film-coated tablets, XL092, XL092, XL092, BELZUTIFAN, Cabozantinib Ipsen 20 mg film-coated tablets, XL092

Primary endpoint: Progression free survival, Overall survival
Endpoint(s): Objective Response Rate, Duration of Response, Number of participants with ≥1 AE(s), Number of participants who discontinue study therapy due to AE(s), Change from baseline in European Organisation for the Research and Treatment of Cancer Quality of Life Questionnaire 30 (EORTC QLQ-C30) global health/health-related quality of life (HRQoL) score, Change from baseline in EORTC QLC-C30 physical functioning score, Change from baseline in EORTC QLQ-C30 role functioning score, Change from baseline in Functional Assessment of Cancer Therapy-Kidney Symptom Index-Disease-related Symptoms (FKSI-DRS) score, Time from baseline to first deterioration in EORTC-QLC-C30 global health/HRQoL score, Time from baseline to first deterioration in EORTC-QLC-C30 physical functioning score, Time from baseline to first deterioration in EORTC-QLC-C30 role functioning score, Time from baseline to first deterioration in FKSI-DRS score

Source: https://euclinicaltrials.eu/ctis-public/view/2024-517136-21-00